EU clinical trial 2023-508126-95-00: A Phase 1 Prospective, Open-label, First-in-human Study to Evaluate the Safety, Tolerability and Biodistribution of [177Lu]Lu-AKIR001 and its Anti-tumour Effect in Adult Patients with CD44v6 Expressing Solid Tumours
Protocol code: AKIR001
Sponsor: Karolinska University Hospital (Hospital/Clinic/Other health care facility). Phase: Human Pharmacology (Phase I)- First administration to humans. Countries: Sweden (ongoing, recruiting).
Therapeutic area(s): Diseases [C] - Neoplasms [C04]
Gender: Female, Male. Age: 18-64 years, 65+ years. Enrolment: 30.
Status: Ongoing, recruiting. Start date (EU): 2025-02-10. Decision date: 2024-09-12. Results received: No. Last updated: 2026-03-06.

Condition(s): The target population of the trial consists of patients with locally advanced irresectable or metastatic solid malignancies, such as advanced thyroid cancer, squamous cell carcinoma originating from head and neck region, vulvar or cervix squamous cell carcinoma, and non-small cell lung cancer.

Source: https://euclinicaltrials.eu/ctis-public/view/2023-508126-95-00